EU clinical trial 2023-505257-40-00: A phase Ib/II single-arm, multicenter study of sacituzumab-govitecan, a TROP-2 targeting antibody linked with SN38, for patients with metastatic esophagogastric adenocarcinoma
Protocol code: SAGA
Sponsor: Institut fuer Klinische Krebsforschung IKF GmbH (Pharmaceutical company). Phase: Phase I and Phase II (Integrated)- Other. Countries: Germany (ended), Austria (ended).
Therapeutic area(s): Diseases [C] - Digestive System Diseases [C06]
Gender: Female, Male. Age: 18-64 years, 65+ years. Enrolment: 67.
Status: Ended. Start date (EU): 2024-04-17. End date (EU): 2026-01-07. Decision date: 2023-10-18. Results received: No. Last updated: 2025-07-22.
Decision dates by country: AT: 2024-05-29, DE: 2023-10-18

Condition(s): metastatic esophagogastric adenocarcinoma (Stage IV)
Product: SACITUZUMAB GOVITECAN

Primary endpoint: Overall response rate (ORR; complete response [CR] + partial response [PR])

Source: https://euclinicaltrials.eu/ctis-public/view/2023-505257-40-00